EU clinical trial 2024-514783-78-00: BOOSTCAMP - Boosting the endocannabinoid system before the treatment of anxiety symptoms
Protocol code: 20U-0014
Sponsor: Universitair Medisch Centrum Utrecht (Hospital/Clinic/Other health care facility). Phase: Therapeutic exploratory (Phase II). Countries: Netherlands (ongoing, recruitment ended).
Therapeutic area(s): Psychiatry and Psychology [F] - Mental Disorders [F03]
Gender: Female, Male. Age: 18-64 years. Enrolment: 82.
Status: Ongoing, recruitment ended. Start date (EU): 2024-10-29. Decision date: 2024-10-29. Results received: No. Last updated: 2024-10-29.

Condition(s): psychological disorders: PTSD; Anxiety disorders
Product: Softisan 378, Cannabidiol

Primary endpoint: Beck’s anxiety index between the first and second week.
Endpoint(s): Effect of CBD on Fear extinction (i.e. physiological responses and subjective fear), Effect of CBD on stress regulation with the Maastricht Acute Stress Test (MAST; i.e. Subjective stress, physiological responses, alpha-amylase and cortisol), Effect of CBD on Sleep quality (i.e. questionnaires and a sleep watch)

Source: https://euclinicaltrials.eu/ctis-public/view/2024-514783-78-00